EU clinical trial 2024-513009-30-00: A Phase 2a Multicenter, Randomized, Platform Study of Targeted Therapies for the Treatment of Adult Subjects with Moderate to Severe Crohn’s Disease
Protocol code: M24-885
Sponsor: AbbVie Deutschland GmbH & Co. KG (Pharmaceutical company). Phase: Therapeutic exploratory (Phase II). Countries: Slovenia (ongoing, recruiting), Belgium (ongoing, recruiting), Slovakia (ongoing, recruiting), France (ongoing, recruiting), Italy (ongoing, recruiting), Spain (ongoing, recruiting), Bulgaria (ongoing, recruiting), Hungary (ongoing, recruiting), Croatia (ongoing, recruiting), Czechia (ongoing, recruiting), Romania (ongoing, recruiting), Ireland (ongoing, recruiting), Germany (ongoing, recruiting), Lithuania (ongoing, recruiting), Portugal (ongoing, recruiting), Netherlands (ongoing, recruiting), Estonia (ongoing, recruiting), Poland (ongoing, recruiting), Latvia (ongoing, recruiting), Austria (ongoing, recruiting), Denmark (ongoing, recruiting), Finland (ongoing, recruiting), Norway (ongoing, recruiting).
Therapeutic area(s): Diseases [C] - Digestive System Diseases [C06]
Gender: Female, Male. Age: 18-64 years, 65+ years. Enrolment: 572.
Status: Ongoing, recruiting. Start date (EU): 2024-11-21. Decision date: 2024-11-11. Results received: No. Last updated: 2026-06-29.
Decision dates by country: LV: 2024-11-14, IE: 2024-11-15, FI: 2025-03-24, NL: 2024-11-14, RO: 2024-11-18, SK: 2024-11-12, FR: 2024-12-19, DE: 2024-11-12, AT: 2024-11-18, PT: 2024-11-12, IT: 2024-11-13, NO: 2025-03-07, BG: 2024-11-14, BE: 2024-11-11, HU: 2024-11-13, ES: 2024-11-18, PL: 2024-11-18, HR: 2024-11-19, LT: 2024-11-13, SI: 2024-11-14, DK: 2025-03-13, CZ: 2024-11-13, EE: 2024-11-18

Condition(s): Moderate to Severe Crohn’s Disease
Product: ABBV-382, ABBV-066 / Risankizumab, ABBV-8736, ABBV-066, Lutikizumab

Primary endpoint: Achievement of endoscopic remission at Week 12.
Endpoint(s): Clinical remission per Crohn's disease activity index (CDAI) at Week 12., Clinical remission per stool frequency (SF)/abdominal pain score (APS) at Week 12., Endoscopic response at Week 12.

Source: https://euclinicaltrials.eu/ctis-public/view/2024-513009-30-00